EU clinical trial 2025-523957-32-00: Steroids and/ or Non-steroidal Anti-inflammatory Drugs in the Postoperative Regime After Trabeculectomy. (SNAP)
Sponsor: Rigshospitalet (Hospital/Clinic/Other health care facility). Phase: Therapeutic use (Phase IV). Countries: Denmark (ended).
Therapeutic area(s): Diseases [C] - Eye Diseases [C11]
Gender: Female, Male. Age: 18-64 years, 65+ years. Enrolment: 72.
Status: Ended. Start date (EU): 2025-10-17. End date (EU): 2026-05-21. Decision date: 2025-10-17. Results received: No. Last updated: 2025-10-17.

Condition(s): Medically uncontrolled glaucoma that requires filtration surgery.
Product: Monopex, øjendråber, opløsning, enkeltdosisbeholder, Voltaren® ophtha sine 1 mg/ml Augentropfen

Primary endpoint: The primary outcome is the intraocular pressure 12 months after surgery measured by applanation tonometry.
Endpoint(s): Postoperative intraocular pressure at 24 months, Best corrected visual acuity (logMAR) at 12 and 24 months, Changes in visual field at 12 and 24 months, Optical nerve damage assessed by measuring retinal nerve fiber layer thickness (RNFL) by peripapillary optical coherence tomography (OCT) at 12 and 24 months, Lens evaluation at, 12- and 24 months by pentacam, Bleb morphology at 12 and 24 months, Surgical success at 12 and 24 months

Source: https://euclinicaltrials.eu/ctis-public/view/2025-523957-32-00